EU clinical trial 2024-512495-35-00: Adjuvant treatment with Pramipexole for anhedonia symptoms in depression - PRIME-PRAXOL
Sponsor: Region Skane (Hospital/Clinic/Other health care facility). Phase: Therapeutic confirmatory (Phase III). Countries: Sweden (ended).
Therapeutic area(s): Psychiatry and Psychology [F] - Mental Disorders [F03]
Gender: Female, Male. Age: 18-64 years, 65+ years. Enrolment: 140.
Status: Ended. Start date (EU): 2022-10-16. End date (EU): 2025-09-25. Decision date: 2024-04-15. Results received: No. Last updated: 2025-07-28.

Condition(s): Major depression
Product: PRAMIPEXOLE, Placebo, PRAMIPEXOLE, PRAMIPEXOLE, PRAMIPEXOLE

Primary endpoint: SHAPS-C (total SHAPS-C scores at baseline, week 3, week 6 and week 9).
Endpoint(s): HDRS6 scores (subscale of HDRS-17)., Number of steps/day, movement pattern distribution over the day, walking distance, time spent in light, moderate and intense physical activity, resting heart rate, blood oxygen saturation, heart rate variability (stress scores), sleep latency, sleep awakening, wakefulness, time in deep sleep, sleep efficiency. All variables are measured using activity meters., Total scores of DARS-SV-MOD, MADRS, AES, Insomnia Severity Scale GAD-7 and BBQ., BOLD activity in the nucleus accumbens during fMRI (MID task)., Biomarkers related to dopamine and inflammation, measured in blood and CSF. BOLD activity in the nucleus accumbens during MID task fMRI and connectivity during diffusion tensor imaging., Gathering of adverse events., Neuropsychological test battery consisting of WAIS-IV, RBANS, D-KEFS, CPT-3 and cognitive self-assessment PDQ-5., The test Probabilistic Reward Task (PRT)

Source: https://euclinicaltrials.eu/ctis-public/view/2024-512495-35-00